EU clinical trial 2024-519833-51-00: The efficacy of pipamperone and aripiprazole on behaviors that challenge in people with intellectual disabilities: A series of N-of-1 cross-over trials
Protocol code: 2024-519833-51-00
Sponsor: Stichting GGZ Drenthe (Hospital/Clinic/Other health care facility). Phase: Therapeutic use (Phase IV). Countries: Netherlands (authorised, recruitment pending).
Therapeutic area(s): Psychiatry and Psychology [F] - Behavioral Disciplines and Activities [F04]; Psychiatry and Psychology [F] - Mental Disorders [F03]
Gender: Female, Male. Age: 0-17 years, 18-64 years, 65+ years. Enrolment: 45.
Status: Authorised, recruitment pending. Decision date: 2026-01-28. Results received: No. Last updated: 2026-04-03.

Condition(s): Behaviors that challenge
Product: Aripiprazol Prolepha 2,5 mg tabletten, Dipiperon 40 mg, tabletten

Primary endpoint: The severity of behaviors that challenge over time measured with the Aberrant Behavior Checklist- Irritability (ABC-I) under treatment with pipamperone compared to a period without pipamperone, and under treatment with aripiprazole compared to a period without aripiprazole.
Endpoint(s): The severity of behaviors that challenge over time measured on the Clinical Global Impression of Severity (CGI-S) and the Clinical Global Impression of Improvement (CGI-I) under treatment with pipamperone compared to a period without pipamperone, and under treatment with aripiprazole compared to a period without aripiprazole., The symptoms and severity of behaviors that challenge over time measured on the separate subscales of the Aberrant Behavior Checklist (ABC) under antipsychotic treatment compared to a period without antipsychotic treatment., The symptoms and severity of the targeted behaviors that challenge over time measured on the Ecological Momentary Assessments (EMA) under antipsychotic treatment compared to a period without antipsychotic treatment., Quality of life measured under antipsychotic treatment compared to a period without antipsychotic treatment. The quality of life is measured over time on the Euro-QoL-5D (EQ-5D-5L)., Daily functioning measured under antipsychotic treatment compared to a period without antipsychotic treatment. Daily functioning is measured over time on the World Health Organisation Disability Assessment Scale-12 (WHODAS-12)., The severity of side effects under antipsychotic treatment compared to a period without antipsychotic treatment. Side effects are measured over time with the Matson Evaluation Drug Side-effects (MEDS)., The correlation between the severity of targeted behavioral symptoms measured on the Ecological Momentary Assessment (EMA) and the severity of behaviors that challenge measured on the Clinical Global Impression scale (CGI) and the Aberrant Behavior Checklist (ABC) after each treatment period., The frequency of rescue medication under antipsychotic treatment compared with a period without antipsychotic treatment. These data are measured over time with the interval history.

Source: https://euclinicaltrials.eu/ctis-public/view/2024-519833-51-00